EU clinical trial 2024-519633-35-00: SURVIVAL ANALYSIS AFTER NEOADJUVANT TREATMENT IN RESECTABLE PANCREATIC CANCER WITH RISK FACTORS
Sponsor: La Fundacion Para La Gestion De La Investigacion Biomedica De Cadiz (Laboratory/Research/Testing facility). Phase: Therapeutic use (Phase IV). Countries: Spain (ended).
Therapeutic area(s): Diseases [C] - Neoplasms [C04]
Gender: Female, Male. Age: 18-64 years, 65+ years. Enrolment: 116.
Status: Ended. Start date (EU): 2021-10-25. End date (EU): 2025-12-18. Decision date: 2024-11-28. Results received: Yes. Last updated: 2024-11-28.

Condition(s): Resectable pancreatic adenocarcinoma with risk factors
Product: IRINOTECAN, FLUOROURACIL, CALCIUM FOLINATE, OXALIPLATIN

Primary endpoint: Overall Survival: Time a patient lives from the date of treatment initiation to exitus. The start date of treatment will be the date of surgery (in case of patients in the control arm) or the date of cycle 1 of chemotherapy (in case of patients in the experimental arm).
Endpoint(s): Invasive disease-free survival and event-free survival: The time a patient lives (or survives) without relapse of invasive disease after treatment (number of months until local or metastatic disease relapse). Whether the relapse is local or metastatic shall be specified., Number of cycles completed by patients., Monitoring of the appearance of new lesions., CA19,9 levels., Types of post-surgical events. Clavien-Dindo (C-D) classification and the 2016 update International Study Group of Pancreatic Fistula (ISGPF) classification. Delayed Gastric Emptying (DGE) and post-surgical bleeding classification ISGPF 2007., R0 resection rates., Number and nature of adverse events, Number and/or percentage of patients with intention to treat., QLQ-C30 quality of life questionnaire

Source: https://euclinicaltrials.eu/ctis-public/view/2024-519633-35-00